EU clinical trial 2024-520214-22-00: A clinical study of MK-7228 in healthy men (MK-7228-001)
Protocol code: MK-7228-001
Sponsor: Merck Sharp & Dohme LLC (Pharmaceutical company). Phase: Human Pharmacology (Phase I)- First administration to humans. Countries: Belgium (ended).
Therapeutic area(s): Diseases [C] - Cardiovascular Diseases [C14]
Gender: Male. Age: 18-64 years. Enrolment: 52.
Status: Ended. Start date (EU): 2025-03-24. End date (EU): 2026-04-02. End date: 2026-04-03. Decision date: 2025-03-11. Results received: No. Last updated: 2026-03-04.

Condition(s): Atherosclerosis

Source: https://euclinicaltrials.eu/ctis-public/view/2024-520214-22-00